EU clinical trial 2024-512210-18-00: A prospective randomized, single blind, controlled, safety and non-inferiority study of esketamine plus propofol compared to methohexital anesthesia for electroconvulsive therapy
Sponsor: Medical University Of Vienna (Educational Institution). Phase: Phase III and phase IV (Integrated). Countries: Austria (ongoing, recruitment ended).
Therapeutic area(s): Psychiatry and Psychology [F] - Mental Disorders [F03]
Gender: Female, Male. Age: 18-64 years, 65+ years. Enrolment: 100.
Status: Ongoing, recruitment ended. Start date (EU): 2024-08-01. Decision date: 2024-07-09. Results received: No. Last updated: 2024-07-09.

Condition(s): major depression
Product: Ketanest® S 25 mg/ml - Ampullen, Propofol „Fresenius" 1 % mit MCT - Emulsion zur Injektion oder Infusion, Brevimytal® Hikma, 500 mg, Pulver zur Herstellung einer Injektions- bzw. Infusionslösung

Primary endpoint: HAMD17 change between baseline and post-ECT in both treatment arms over a series of 8 ECT sessions, Mean recovery time over 8 ECT sessions in both treatment arms
Endpoint(s): The total use of concomitant medication to treat postictal hypertension, tachycardia and agitation (urapidil, metoprolol and clonidin in mg, respectively) summed over 8 ECT sessions will be compared between the ketofol and the methohexital arms., Ketofol anesthesia will be non-inferior to methohexital use in terms of seizure quality. The applied stimulus charge at the 8th session can be considered an indirect measure of seizure quality and duration as the stimulus charge has to be increased throughout the ECT series if seizure duration and quality are insufficient (non-inferiority margin for final stimulus charge: 20 mC)., We will assess the change of cognitive outcomes (8 tests including MMSE), as assessed using a comprehensive test battery before the first and after the last treatment (see methods section), in both treatment arms, and compare these changes between treatment arms., We will compare the average time to reorientation (TRO) over 8 ECT sessions in both treatment arms. We hypothesize that TRO might be correlated with cognitive outcomes in both treatment arms., As ketamin has a known potential of causing liver injury, laboratory markers of liver injury (ALT, AST, gamma-GT, albumin, normotest) will be monitored at baseline, at the 4th ECT session and at termination of the course., We will assess changes of blood pressure and heart rate between induction of anesthesia and immediately following seizure cessation (postictal), the occurrence of agitation during recovery (assessing changes in RASS score between induction of anesthesia and recovery) and change of markers of cardiac injury (pro-BNP, troponin T, CK-MB) before, early after (0-2h) and 24h after ECT session 1, 4 and 8. These changes will be compared between treatment arms.

Source: https://euclinicaltrials.eu/ctis-public/view/2024-512210-18-00